EU clinical trial 2024-516232-10-00: Defining Antibiotic Levels in Intensive care patients (DALI-2) protocol - A multi-national pharmacokinetic/pharmacodynamic cohort study to determine whether contemporary antibiotic dosing for critically ill patients achieves therapeutic exposures.
Protocol code: LOCAL/2024/CR-03
Sponsor: Centre Hospitalier Universitaire De Nimes (Hospital/Clinic/Other health care facility). Phase: Therapeutic use (Phase IV). Countries: France (authorised, recruitment pending).
Therapeutic area(s): Diseases [C] - Bacterial Infections and Mycoses [C01]; Analytical, Diagnostic and Therapeutic Techniques and Equipment [E] - Anesthesia and Analgesia [E03]
Gender: Female, Male. Age: 18-64 years, 65+ years. Enrolment: 200.
Status: Authorised, recruitment pending. Decision date: 2025-10-17. Results received: No. Last updated: 2025-10-17.

Condition(s): Serious infections in critically ill patients treated with antibiotics
Product: BENZYLPENICILLIN, LINEZOLID, MEROPENEM, CEFIDEROCOL, IMIPENEM AND CILASTATIN, LEVOFLOXACIN, AZTREONAM AND BETA-LACTAMASE INHIBITOR, CEFTAZIDIME, AZTREONAM, COLISTIN, CLOXACILLIN, AMOXICILLIN, VANCOMYCIN, AMOXICILLIN AND BETA-LACTAMASE INHIBITOR, CEFTAZIDIME AND BETA-LACTAMASE INHIBITOR, ERTAPENEM, TIGECYCLINE, AMPICILLIN AND BETA-LACTAMASE INHIBITOR, IMIPENEM, CILASTATIN AND RELEBACTAM, FOSFOMYCIN, TEICOPLANIN, AMPICILLIN, GENTAMICIN, DAPTOMYCIN, PIPERACILLIN AND BETA-LACTAMASE INHIBITOR, SULFAMETHOXAZOLE AND TRIMETHOPRIM, CEFEPIME, CEFOTAXIME, CEFTOLOZANE AND BETA-LACTAMASE INHIBITOR, MEROPENEM AND VABORBACTAM, CEFTRIAXONE, TOBRAMYCIN, CIPROFLOXACIN, METRONIDAZOLE, AMIKACIN, PIPERACILLIN, FLUCLOXACILLIN, CEFAZOLIN

Primary endpoint: The primary endpoint is the antibiotic PK/PD plasma target defined in Table 1 for each study drug. Antibiotic plasma concentrations will be measured as described in Section 10 of the protocol.
Endpoint(s): Alternative PK/PD targets: i. 50% fT>MIC, 50% fT>4xMIC, 100%fT>MIC and 100%fT>4xMIC for beta-lactam antibiotics. ii. In adults, a trough concentration of ≥15 mg/L, and 15 to 25 mg/L for vancomycin intermittent and continuous infusions. iii. In children, a trough concentration range of 15 to 20 mg/L for methicillin-resistant Staphylococcus aureus (MRSA) and 10 to 15 mg/L for non-MRSA., Correlation between targeted antibiotic plasma concentrations and i. Clinical success ii. Clinical failure iii. Mortality at day 14 and day 30 after initiation of the study antibiotic. iv. The number of ICU free days at day 30 after initiation of the study antibiotic. v. Identification of resistant organisms in the subsequent microbiological samples within 14 days of study antibiotic start., Proportion of patients whose observed antibiotic concentrations surpass the pre-defined values associated with toxicity, Correlation between antibiotic plasma concentrations and the occurrence of adverse events, Description of observed antibiotic plasma concentrations

Source: https://euclinicaltrials.eu/ctis-public/view/2024-516232-10-00